EU clinical trial 2024-518889-27-00: A study to investigate the safety and tolerability of SDL-M1 nanoparticles in healthy volunteers
Protocol code: SDL-M001
Sponsor: SmartDyeLivery GmbH (Pharmaceutical company). Phase: Human Pharmacology (Phase I)- First administration to humans. Countries: Germany (ongoing, recruitment ended).
Therapeutic area(s): Diseases [C] - Bacterial Infections and Mycoses [C01]
Gender: Female, Male. Age: 18-64 years. Enrolment: 48.
Status: Ongoing, recruitment ended. Start date (EU): 2026-04-02. Decision date: 2024-11-15. Results received: No. Last updated: 2026-04-20.

Condition(s): Septic cholestasis

Source: https://euclinicaltrials.eu/ctis-public/view/2024-518889-27-00